EU clinical trial 2025-522692-29-00: Randomized, Double-Blinded, Vehicle-Controlled, Parallel Group, Adaptive Proof-of-concept, Dose-selecting Phase 2a Study to Evaluate the Safety, Tolerability, Pharmacokinetics, Pharmacodynamics and Efficacy of Intranasal Cenegermin (recombinant human Nerve Growth Factor [rhNGF]) in Adult Participants with subacute moderate to severe Traumatic Brain Injury (TBI).
Protocol code: NGF-TBI-201
Sponsor: Dompe' Farmaceutici S.p.A. (Pharmaceutical company). Phase: Therapeutic exploratory (Phase II). Countries: Italy (authorised, recruitment pending), Denmark (authorised, recruitment pending), Finland (authorised, recruitment pending), France (authorised, recruitment pending), Germany (authorised, recruitment pending), Spain (authorised, recruitment pending), Sweden (authorised, recruitment pending), Poland (authorised, recruiting).
Therapeutic area(s): Diseases [C] - Nervous System Diseases [C10]
Gender: Female, Male. Age: 18-64 years, 65+ years. Enrolment: 146.
Start date (EU): 2026-07-13. Decision date: 2026-04-14. Results received: No. Last updated: 2026-07-17.
Decision dates by country: FI: 2026-04-15, FR: 2026-04-14, PL: 2026-04-20, ES: 2026-04-16, IT: 2026-04-15, DK: 2026-04-14, SE: 2026-04-14, DE: 2026-04-15

Condition(s): Subacute Moderate to Severe Traumatic Brain Injury (TBI)
Product: Cenegermin, Vehicle

Primary endpoint: 1. Incidence of treatment-emergent serious and non-serious adverse events through 6 months following the first intranasal administration of cenegermin.
Endpoint(s): 1. Sliding and good outcome in Glasgow Outcome Scale – Extended at month 6., 2. Through 12 months following the first administration of investigational product., 3. Incidence of treatment-emergent serious and non-serious adverse events, and adverse events of special interest., 4. Participant incidence of study discontinuation for tolerability reasons., 5. Change from baseline on vital signs, 12-lead ECG results, clinical laboratory assessments, physical examinations, brain MRI, C-SSRS and blood levels of ADA.

Source: https://euclinicaltrials.eu/ctis-public/view/2025-522692-29-00